EU clinical trial 2023-506199-28-00: A Phase 1, Open-Label, Multicenter, First-in-Human Study to Evaluate the Safety, Tolerability, Pharmacokinetics, Pharmacodynamics, and Preliminary Anti-Tumor Activity of VVD130037, in Participants With Advanced Solid Tumors
Protocol code: VVD-130037-001
Sponsor: Vividion Therapeutics Inc. (Pharmaceutical company). Phase: Human Pharmacology (Phase I)- First administration to humans. Countries: Spain (ongoing, recruiting).
Therapeutic area(s): Diseases [C] - Neoplasms [C04]
Gender: Female, Male. Age: 18-64 years, 65+ years. Enrolment: 65.
Status: Ongoing, recruiting. Start date (EU): 2024-08-05. Decision date: 2023-11-16. Results received: No. Last updated: 2026-07-22.

Condition(s): Dose escalation: Advanced Solid Tumors Dose Expansion: Squamous non-small cell lung cancer

Source: https://euclinicaltrials.eu/ctis-public/view/2023-506199-28-00